EU clinical trial 2023-509345-12-00: A randomized, double-blind, double-dummy, parallel-group study, comparing the efficacy and safety of remibrutinib versus teriflunomide in participants with relapsing multiple sclerosis, followed by extended treatment with open-label remibrutinib
Protocol code: CLOU064C12301
Sponsor: Novartis Pharma AG (Pharmaceutical company). Phase: Therapeutic confirmatory (Phase III). Countries: Austria (ongoing, recruitment ended), Belgium (ongoing, recruitment ended), Poland (ongoing, recruitment ended), Croatia (ongoing, recruitment ended), Slovakia (ongoing, recruitment ended), Bulgaria (ongoing, recruitment ended), Lithuania (ongoing, recruitment ended), Denmark (ended), Netherlands (ended), Ireland (ongoing, recruitment ended), Spain (ongoing, recruitment ended), Italy (ongoing, recruitment ended), Latvia (ongoing, recruitment ended).
Therapeutic area(s): Diseases [C] - Nervous System Diseases [C10]
Gender: Female, Male. Age: 18-64 years. Enrolment: 464.
Start date (EU): 2022-06-22. Decision date: 2024-06-20. Results received: No. Last updated: 2026-06-18.
Decision dates by country: DK: 2024-06-20, AT: 2024-06-24, HR: 2024-06-21, BE: 2024-06-21, NL: 2024-06-20, PL: 2024-06-21, IE: 2024-06-20, LV: 2024-06-20, ES: 2024-06-24, BG: 2024-07-01, LT: 2024-07-17, IT: 2024-06-24, SK: 2024-06-20

Condition(s): Multiple Sclerosis
Product: MEDICINAL CHARCOAL, LOU064, COLESTYRAMINE, Placebo to teriflunomide 14 mg capsule, hard, TERIFLUNOMIDE, Placebo to Remibrutinib (LOU064) 100 mg film-coated tablet

Primary endpoint: Annualized relapse rate (ARR) of confirmed relapses
Endpoint(s): Time to 3-month confirmed disability progression (3mCDP) on Expanded Disability Status Scale (EDSS), Time to 6-month confirmed disability progression (6mCDP) on EDSS, Number of new or enlarging T2 lesions on MRI per year (annualized T2 lesion rate), Total number of Gd-enhancing T1 lesions per MRI scan, Neurofilament light chain (NfL) concentration in serum, Percentage of participants with No Evidence of Disease Activity-3 (NEDA-3), as assessed by absence of confirmed MS relapses, 6mCDP and new/enlarging T2 lesions on MRI, Time to first confirmed relapse, Time to 6-month confirmed disability improvement (6mCDI) on EDSS (pooled data), Time to 3mCDP and 6mCDP independent of relapse activity (PIRA, pooled data), Change from baseline in the Symbol Digit Modalities Test (SDMT) (pooled data), Time to 6-month confirmed worsening by at least 20% in the: ● Timed 25-foot walk test (T25FW) (pooled data) ● Timed 9-hole peg test (9HPT) (pooled data), Time to composite 6-month confirmed disability progression, as evaluated by 6mCDP or 6-month confirmed worsening by at least 20% in T25FW or 9HPT (pooled data), Change from baseline in T2 lesion volume, Multiple Sclerosis Impact Scale (MSIS-29), Adverse events, laboratory data, vital signs, electrocardiogram (ECG), Columbia Suicide Severity Rating, Remibrutinib blood concentrations, Extension Part: ● Adverse events, laboratory data, vital signs, electrocardiogram (ECG), Columbia Suicide Severity Rating ● ARR, number of new or enlarging T2 lesions on MRI per year (annualized T2 lesion rate), time to 6mCDP (EDSS), change in SDMT, NfL, Patient Reported Outcomes scores

Source: https://euclinicaltrials.eu/ctis-public/view/2023-509345-12-00